EU clinical trial 2023-507655-30-00: I8F-MC-GPIX: Efficacy and Safety of Tirzepatide Once Weekly Versus Placebo for the Treatment of Obesity and Weight-Related Comorbidities in Adolescents: A Randomized, Double-Blind, Placebo- Controlled Trial (SURMOUNT-ADOLESCENTS-2)
Protocol code: I8F-MC-GPIX
Sponsor: Eli Lilly & Co. (Pharmaceutical company). Phase: Therapeutic confirmatory (Phase III). Countries: France (ongoing, recruitment ended), Germany (ongoing, recruitment ended), Spain (ongoing, recruitment ended).
Therapeutic area(s): Diseases [C] - Nutritional and Metabolic Diseases [C18]
Gender: Female, Male. Age: 0-17 years. Enrolment: 43.
Status: Ongoing, recruitment ended. Start date (EU): 2024-09-27. Decision date: 2024-09-05. Results received: No. Last updated: 2026-07-28.
Decision dates by country: FR: 2024-09-05, ES: 2024-09-09, DE: 2024-09-26

Condition(s): Obesity
Product: Tirzepatide, Tirzepatide, Placebo to match LY3298176 injection, Tirzepatide, Tirzepatide, Tirzepatide, Tirzepatide

Primary endpoint: Percent Change from Baseline in Body Mass Index (BMI), A Composite Endpoint of Normalization or Clinically Significant Improvement in At Least 2 Predefined Weight-Related Comorbidities Present at Screening Without Development of a New Predefined Comorbidity Or Worsening of an Existing Predefined Comorbidity

Source: https://euclinicaltrials.eu/ctis-public/view/2023-507655-30-00